EU clinical trial 2024-516209-21-00: Characterization of cerebral tau aggregates with 18F-RO6958948 PET in the ALFA population
Protocol code: tau-PET/BBRC2019
Sponsor: Barcelonabeta Brain Research Center (Laboratory/Research/Testing facility). Phase: Therapeutic exploratory (Phase II). Countries: Spain (authorised, recruiting).
Therapeutic area(s): Health Care [N] - Population Characteristics [N01]
Gender: Female, Male. Age: 18-64 years, 65+ years. Enrolment: 200.
Status: Authorised, recruiting. Start date (EU): 2024-12-18. Decision date: 2024-12-18. Results received: No. Last updated: 2026-03-31.

Condition(s): Alzheimer's Disease

Primary endpoint: Global and regional retention rate of 18F-RO6958948

Source: https://euclinicaltrials.eu/ctis-public/view/2024-516209-21-00